EU clinical trial 2025-522033-64-00: A Phase 1 Study of AJ1-11095 in Adults with Myelofibrosis Failed by a JAK2 Inhibitor
Protocol code: AJX-101
Sponsor: Ajax Therapeutics Inc. (Pharmaceutical company). Phase: Human Pharmacology (Phase I)- First administration to humans. Countries: Italy (authorised, recruiting), France (ongoing, recruiting), Spain (ongoing, recruiting).
Therapeutic area(s): Diseases [C] - Neoplasms [C04]; Diseases [C] - Hemic and Lymphatic Diseases [C15]
Gender: Female, Male. Age: 18-64 years, 65+ years. Enrolment: 20.
Start date (EU): 2026-02-26. Decision date: 2026-02-09. Results received: No. Last updated: 2026-03-06.
Decision dates by country: IT: 2026-02-11, FR: 2026-02-09, ES: 2026-03-03

Condition(s): Myelofibrosis

Source: https://euclinicaltrials.eu/ctis-public/view/2025-522033-64-00